EU clinical trial 2025-521902-17-00: Phase 1/2 multicenter, two-arms, open-label, dose-escalation study of IDP-121 in combination with chemotherapy in patients with relapsed small cell lung cancer (SCLC) (MYCrocytic)
Protocol code: IDP-121-2 MYCrocytic
Sponsor: Idp Discovery Pharma S.L. (Pharmaceutical company). Phase: Phase I and Phase II (Integrated)- Other. Countries: Spain (ongoing, recruiting).
Therapeutic area(s): Diseases [C] - Neoplasms [C04]
Gender: Female, Male. Age: 18-64 years, 65+ years. Enrolment: 60.
Status: Ongoing, recruiting. Start date (EU): 2026-07-09. Decision date: 2025-12-18. Results received: No. Last updated: 2026-05-04.

Condition(s): Unresectable/metastatic Small cell Lung Cancer (SCLC)
Product: IDP-121 Concentrate for solution for infusion 3 mg/mL

Primary endpoint: Dose-Escalation (Phase 1) Primary Endpoint(s): • Maximum tolerated dose (MTD): based on the incidence of DLTs observed at the end of Cycle 1 (21 days). • Recommended phase 2 dose (RP2D): dose selected for the use in the expansion phase. The RP2D will be determined in discussion with the Investigators and the Sponsor based on safety (dose limiting toxicity), PK, PD, and efficacy observed across multiple dose-escalation cohorts., Expansion-Phase (Phase 2) Primary Endpoint: The primary endpoint for the Expansion-Phase is the Overall Response Rate (ORR) and the disease control rate (DCR) based on the appropriate tumour specific guidelines/response criteria RECIST 1.1
Endpoint(s): The secondary efficacy endpoints for the Expansion Phase: • Duration of response (DoR), defined as the time from documentation of disease response to disease progression., • Time to progression (TTP), time from the first treatment day to objective disease progression; does not include deaths., • Overall survival (OS) defined as the interval between the first treatment day to death from any cause., The secondary safety endpoints for the Expansion Phase are as follows: • Vital signs • Physical examination • Hematology • Biochemistry • Urinalysis • Electrocardiograms (ECG) • All grades AEs and SAEs

Source: https://euclinicaltrials.eu/ctis-public/view/2025-521902-17-00